EU clinical trial 2024-515599-11-00: An investigator-initiated, single-center academic study in healthy transgender and cisgender persons aged between 18 and 50 years to investigate gender and sex differences in immune responses to meningococcal serogroup B vaccination
Sponsor: Universiteit Gent (Educational Institution). Phase: Therapeutic use (Phase IV). Countries: Belgium (ongoing, recruiting).
Therapeutic area(s): Phenomena and Processes [G] - Immune system processes [G12]
Gender: Female, Male. Age: 18-64 years. Enrolment: 250.
Status: Ongoing, recruiting. Start date (EU): 2025-01-30. Decision date: 2024-12-19. Results received: No. Last updated: 2026-06-09.

Condition(s): Healthy volunteers
Product: Bexsero suspension for injection in pre-filled syringe Meningococcal group B Vaccine (rDNA, component, adsorbed), Bexsero suspension for injection in pre-filled syringe Meningococcal group B Vaccine (rDNA, component, adsorbed), Bexsero suspension for injection in pre-filled syringe Meningococcal group B Vaccine (rDNA, component, adsorbed), Bexsero suspension for injection in pre-filled syringe Meningococcal group B Vaccine (rDNA, component, adsorbed), Bexsero suspension for injection in pre-filled syringe Meningococcal group B Vaccine (rDNA, component, adsorbed), Bexsero suspension for injection in pre-filled syringe Meningococcal group B Vaccine (rDNA, component, adsorbed), Bexsero suspension for injection in pre-filled syringe Meningococcal group B Vaccine (rDNA, component, adsorbed), Bexsero suspension for injection in pre-filled syringe Meningococcal group B Vaccine (rDNA, component, adsorbed), Bexsero suspension for injection in pre-filled syringe Meningococcal group B Vaccine (rDNA, component, adsorbed), Bexsero suspension for injection in pre-filled syringe Meningococcal group B Vaccine (rDNA, component, adsorbed), Bexsero suspension for injection in pre-filled syringe Meningococcal group B Vaccine (rDNA, component, adsorbed), Bexsero suspension for injection in pre-filled syringe Meningococcal group B Vaccine (rDNA, component, adsorbed), Bexsero suspension for injection in pre-filled syringe Meningococcal group B Vaccine (rDNA, component, adsorbed), Bexsero suspension for injection in pre-filled syringe Meningococcal group B Vaccine (rDNA, component, adsorbed), Bexsero suspension for injection in pre-filled syringe Meningococcal group B Vaccine (rDNA, component, adsorbed), Bexsero suspension for injection in pre-filled syringe Meningococcal group B Vaccine (rDNA, component, adsorbed)

Primary endpoint: Quantification of human serum bactericidal antibody titers (hSBA) against reference strains for factor H binding protein (fHbp), Neisseria adhesin A (NadA) and Porine A (PorA) in serum collected at Day 0 and 28 (prior to primary and secondary vaccination, respectively), and 56 days post-primary vaccination with 4CMenB in transgender and cisgender participants. The results will be evaluated on a defined subset of the collected samples., Comparison of hSBA antibody titers against reference strains for fHbp, NadA and PorA in serum samples collected at Day 0 and 28 (prior to primary and secondary vaccination, respectively), and 56 days post-primary vaccination with 4CMenB between transgender and cisgender participants. The results will be evaluated on a defined subset of the collected samples.
Endpoint(s): Quantification of T cell-mediated immune responses in peripheral blood mononuclear cells (PBMCs) collected at Day 0 (prior to primary vaccination, baseline), and 56 days post-primary vaccination with 4CMenB in transgender and cisgender participants. The results will be expressed as frequencies of CD4+ or CD8+ T cells responding to 4CMenB antigen(s) and expressing two or more immune markers among CD40L, IFN-γ, IL-2, and TNF-α per million total CD4+ or CD8+ T cells as measured using intracellula, Comparison of T cell-mediated immune responses in PBMCs collected at Day 0 (prior to primary vaccination, baseline), and 56 days post-primary vaccination with 4CMenB between transgender and cisgender participants. The results will be expressed as frequencies of CD4+ or CD8+ T cells responding to MenB antigens and expressing two or more immune markers among CD40L, IFN-γ, IL-2 and TNF-α per million total CD4+ or CD8+ T cells as measured using intracellular cytokine staining and flow cytometry (I

Source: https://euclinicaltrials.eu/ctis-public/view/2024-515599-11-00